EU clinical trial 2023-504479-25-00: C1071003 - MAGNETISMM-3, An Open-Label, Multicenter, Non-Randomized Phase 2 Study of Elranatamab (PF-06863135) Monotherapy in Participants With Multiple Myeloma Who Are Refractory to at Least One Proteasome Inhibitor, One Immunomodulatory Drug and One Anti-CD38 Antibody
Protocol code: C1071003
Sponsor: Pfizer Inc. (Pharmaceutical company). Phase: Therapeutic exploratory (Phase II). Countries: Belgium (ended), Poland (ended), France (ongoing, recruitment ended), Germany (ended), Spain (ongoing, recruitment ended).
Therapeutic area(s): Diseases [C] - Neoplasms [C04]
Gender: Female, Male. Age: 18-64 years, 65+ years. Enrolment: 25.
Start date (EU): 2021-08-20. Decision date: 2024-09-04. Results received: No. Last updated: 2025-10-31.
Decision dates by country: DE: 2024-09-05, PL: 2024-09-04, ES: 2024-09-06, BE: 2024-09-09, FR: 2024-09-13

Condition(s): Multiple myeloma
Product: ELRANATAMAB

Primary endpoint: • ORR by BICR per IMWG.
Endpoint(s): • ORR by BICR baseline EMD status per IMWG., • DOR by BICR and investigator per IMWG., • CRR by BICR and investigator per IMWG., • ORR by investigator per IMWG., • DOCR by BICR and investigator per IMWG., • PFS by BICR and investigator per IMWG., • TTR by BICR and investigator per IMWG., • MRD negativity rate (central lab) per IMWG., • AEs and laboratory abnormalities as graded by NCI CTCAE v5.0., • Severity of CRS and ICANS assessed according to ASTCT criteria., • Pre- and postdose concentrations of elranatamab., • ADAs and NAbs against elranatamab., • OS.

Source: https://euclinicaltrials.eu/ctis-public/view/2023-504479-25-00